EU clinical trial 2025-524668-39-00: A Phase IIb, Randomized, Double-Blind, Placebo-Controlled, Multicenter Study of Intra-Articular Allocetra in Patients with Primary Knee Osteoarthritis
Protocol code: ENX-CL-05-002
Sponsor: Enlivex Therapeutics Ltd. (Pharmaceutical company). Phase: Therapeutic exploratory (Phase II). Countries: Denmark (ongoing, recruiting).
Therapeutic area(s): Diseases [C] - Musculoskeletal Diseases [C05]
Gender: Female, Male. Age: 18-64 years, 65+ years. Enrolment: 75.
Status: Ongoing, recruiting. Start date (EU): 2026-05-15. Decision date: 2026-04-13. Results received: No. Last updated: 2026-04-28.

Condition(s): Knee Osteoarthritis
Product: Allocetra-OTS, Matching placebo (vehicle)

Primary endpoint: The change from baseline of the WOMAC Pain score at 3 months between Allocetra and Placebo., The change from baseline for the WOMAC Function score at 3 months., Incidence and severity of Adverse Events (AEs), treatment disruptions/ discontinuations and evaluation of safety laboratory values up to 6 months.
Endpoint(s): The change from baseline of the WOMAC Pain score at 6 months., The change from baseline of the WOMAC Function score at 6 months., The change from baseline for the WOMAC Total score at 3 months., The change from baseline of the WOMAC Total score at 6 months., The change from baseline of the Average Daily Pain Numerical Rating Scale (ADP-NRS) at 3 months., The change from baseline of the ADP-NRS at 6 months.

Source: https://euclinicaltrials.eu/ctis-public/view/2025-524668-39-00